EU clinical trial 2024-510872-18-00: A Phase 2, Randomized, Double-Blind, Placebo-Controlled Dose-Ranging, Parallel and Adaptive Study to Evaluate the Efficacy and Safety of Enpatoran in Systemic Lupus Erythematosus and in Cutaneous Lupus Erythematosus (Subacute Cutaneous Lupus Erythematosus and/or Discoid Lupus Erythematosus) Participants Receiving Standard of Care
Protocol code: MS200569_0003
Sponsor: Merck Healthcare KGaA (Pharmaceutical company). Phase: Therapeutic exploratory (Phase II). Countries: Spain (ended), Greece (ended), Romania (ended), Poland (ended), Bulgaria (ended).
Therapeutic area(s): Diseases [C] - Immune System Diseases [C20]; Diseases [C] - Skin and Connective Tissue Diseases [C17]
Gender: Female, Male. Age: 18-64 years, 65+ years. Enrolment: 127.
Status: Ended. Start date (EU): 2022-05-09. End date (EU): 2025-01-27. End date: 2025-01-28. Decision date: 2024-06-11. Results received: Yes. Last updated: 2025-01-27.
Decision dates by country: GR: 2024-08-22, PL: 2024-07-01, BG: 2024-06-19, ES: 2024-06-11, RO: 2024-07-23

Condition(s): Systemic lupus erythematosus (SLE) and cutaneous lupus erythematosus (CLE)
Product: Enpatoran placebo, Enpatoran, Enpatoran

Primary endpoint: Cohort A: Percent Change from Baseline in Cutaneous Lupus Erythematosus Disease Area and Severity Index (CLASI-A) at Week 16, Cohort B: British Isles Lupus Assessment Group (BILAG)-Based Composite Lupus Assessment (BICLA) Response at Week 24
Endpoint(s): Cohort A and Cohort B: Safety Profile as Assessed by Incidence of Treatment-Emergent Adverse Events (TEAEs), Serious Adverse Events (SAEs), AEs of Special Interest, Clinically Significant Abnormalities in Laboratory Parameters and QT Interval Corrected, Cohort A and Cohort B: Change from Baseline in Cutaneous Lupus Activity Investigator's Global Assessment (CLA-IGA) at Week 16 and Week 24, Cohort A and Cohort B: Change from Baseline in Physician's Global Assessment of Cutaneous Lupus Disease Activity at Week 16 and 24, Cohort B: Participants with British Isles Lupus Assessment Group (BILAG)-Based Composite Lupus Assessment (BICLA) Response and with Clinically Meaningful Corticosteroids (CS) Reduction, Cohort A: Clinically Meaningful Corticosteroids (CS) Reduction, Cohort A: Ocurrence of Cutaneous Lupus Activity Investigator's Global Assessment (CLA-IGA) Score 0 or 1 at Week 16 and Week 24, Cohort B: Systemic lupus Erythematosus Responder Index-4 (SRI-4) Response at Week 24, Cohort B: Lupus Low Disease Activity State (LLDAS) Attainment at Week 24, Cohort B: Remission Attainment at Week 24, Cohort B: Change From Baseline in Tender Joint Count and Swollen Joint Count at Week 24, Cohort B: Change from Baseline in Physician's Global Assessment at Week 24, Cohort B: Time to First Moderate/Severe British Isles Lupus Assessment Group (BILAG) Flare, Cohort B: Time to First Systemic Lupus Erythematosus Disease Activity Index (SLEDAI) Flare Index (SFI) Severe Flare, Cohort A and B: Change from Baseline in Skindex 29+3 Symptom Domain Score at Week 24, Cohort A and B: Change from Baseline in the Skindex 29+3 Functioning and Emotion Domain Scores at Week 24, Change from Baseline in the Skindex 29+3 Lupus-Specific Domain Score at Week 24, Cohort A and B: Change from Baseline in Functional Assessment of Chronic Illness Therapy (FACIT)-Fatigue Scores at Week 24

Source: https://euclinicaltrials.eu/ctis-public/view/2024-510872-18-00